EU clinical trial 2023-507075-22-00: Safety, pharmacokinetics and pharmacodynamics study of Leucettinib-21 in healthy subjects, Down Syndrom and Alzheimer patients
Sponsor: Eurofins Optimed, Perha Pharmaceuticals (Pharmaceutical company). Phase: Human Pharmacology (Phase I)- First administration to humans. Countries: France (ended).
Therapeutic area(s): Diseases [C] - Nervous System Diseases [C10]
Gender: Female, Male. Age: 18-64 years, 65+ years. Enrolment: 140.
Status: Ended. Start date (EU): 2024-01-05. End date (EU): 2026-06-25. Decision date: 2023-12-13. Results received: No. Last updated: 2026-04-15.
Decision dates by country: FR: 2023-12-14

Condition(s): A Phase 1, Randomized, Double-Blind, Placebo-Controlled, First in Human Study to Evaluate the Safety, Tolerability, Pharmacokinetics and Pharmacodynamics of Single and Multiple Ascending Doses and Food Effect of Leucettinib-21 in Healthy Male Subjects, followed by an open single dose of Leucettinib-21 in Down Syndrome individuals, and patients with Alzheimer’s disease

Source: https://euclinicaltrials.eu/ctis-public/view/2023-507075-22-00